EU clinical trial 2024-516404-42-00: Mesenchymal stromal cells treatment in Lyell syndrome: A pilot phase 1-2 open trial (LYSYME)
Protocol code: P150941J
Sponsor: Assistance Publique Hopitaux De Paris (Hospital/Clinic/Other health care facility). Phase: Phase I and Phase II (Integrated)- Other. Countries: France (ongoing, recruiting).
Therapeutic area(s): Diseases [C] - Skin and Connective Tissue Diseases [C17]
Gender: Female, Male. Age: 18-64 years, 65+ years. Enrolment: 30.
Status: Ongoing, recruiting. Start date (EU): 2024-04-15. Decision date: 2024-11-06. Results received: No. Last updated: 2025-06-19.

Condition(s): Adults diagnosed with SJS-TEN with at least 10% of body surface area involved
Product: Allogeneic Mesenchymal stromal cells derived from adipose tissue thawed and cultured

Primary endpoint: Safety: The toxicity is defined as the observation of at least one adverse effect, Efficacy: Rate of complete almost complete reepithelialisation at D7 after infusion. This criterion is defined as at least 90% of cutaneous body surface area (BSA) healed at D7 in comparison to maximal cutaneous detachable-detached BSA observed.
Endpoint(s): Rate of observed and predicted death at one month by the SCORTEN scale, Duration of hospitalisation according to our historical cohort, Duration of each mucous membrane healing i.e. (buccal, nasal, genital, eyes)., Rate of sepsis, Rate of intensive care transfer, Rate of sequelae at M12, Th1/Th2 immune response in the peripheral blood of the patients after injection at D0, D10, M1, Evaluation of expression profile of Th1/Th2 associated chemokines and anti-inflammatory chemokines in the peripheral blood after injection at D0, D10, M1., Epidermal chimerism research on healed skin biopsy and peripheral blood at 1 month., Rate of complete or almost complete reepithelialisation at D5, D10 and D15 after infusion.

Source: https://euclinicaltrials.eu/ctis-public/view/2024-516404-42-00